EU clinical trial 2025-523738-21-00: Randomized, Double-Blind, Placebo-Controlled, Phase 2 Study of MRM-3379 in Male Participants with Fragile X Syndrome
Protocol code: ENV-202
Sponsor: Mirum Pharmaceuticals Inc. (Pharmaceutical company). Phase: Therapeutic exploratory (Phase II). Countries: Spain (authorised, recruitment pending).
Therapeutic area(s): Diseases [C] - Congenital, Hereditary, and Neonatal Diseases and Abnormalities [C16]
Gender: Male. Age: 0-17 years, 18-64 years. Enrolment: 15.
Status: Authorised, recruitment pending. Decision date: 2026-04-27. Results received: No. Last updated: 2026-06-08.

Condition(s): Fragile X Syndrome
Product: MRM-3379, Placebo for MRM-3379, MRM-3379

Primary endpoint: To evaluate the safety and tolerability of MRM-3379 in male participants with FXS on the bases of the following endpoints: -Incidence and severity of TEAEs; - Withdrawal due to AEs.
Endpoint(s): To evaluate the preliminary efficacy of MRM-3379 in male participants with FXS on the basis of the following endpoints: - Key secondary endpoint: Change from baseline on the NIH-TCB Crystallized Cognition Composite (CCC): Composed from the Picture Vocabulary Test (PVT) and Oral Reading Recognition Test (ORRT) change sensitive scores; - Other secondary endpoint: Clinician Global Impression-Change (CGI-C) score, To describe the PK properties of MRM-3379 on the basis of the following endpoint: Steady-state MRM-3379 and metabolite plasma concentrations

Source: https://euclinicaltrials.eu/ctis-public/view/2025-523738-21-00